EU clinical trial 2023-506737-30-00: A Phase 1/2, Open-Label, Dose Escalation Study to Assess the Safety, Tolerability, Pharmacokinetics, and Pharmacodynamics of Multiple Intravenous Doses of BMN 351 in Participants with Duchenne Muscular Dystrophy
Protocol code: 351-201
Sponsor: Biomarin Pharmaceutical Inc. (Pharmaceutical company). Phase: Phase I and Phase II (Integrated)- First administration to humans. Countries: Italy (ongoing, recruitment ended), Spain (ended), Netherlands (ended).
Therapeutic area(s): Diseases [C] - Musculoskeletal Diseases [C05]
Gender: Male. Age: 0-17 years. Enrolment: 6.
Start date (EU): 2024-03-08. Decision date: 2023-11-30. Results received: No. Last updated: 2026-03-13.
Decision dates by country: ES: 2023-11-30, NL: 2024-04-03, IT: 2023-12-01

Condition(s): Duchenne Muscular Dystrophy
Product: Exon 51 specific phosphorothioate oligonucleotide

Primary endpoint: 1. Incidence of adverse events/SAEs/AESI, physical examination, safety laboratory test parameters, ECG parameters, echocardiography, 2. Physical examination, 3. Safety laboratory test parameters, 4. ECG parameters
Endpoint(s): 1. BMN 351 plasma PK, urine PK and concentration in muscle

Source: https://euclinicaltrials.eu/ctis-public/view/2023-506737-30-00